EU clinical trial 2024-511439-84-00: Sequential or up-front triple treatment with durvalumab, tremelimumab and bevacizumab for non-resectable hepatocellular carcinoma (HCC) patients (MONTBLANC)
Protocol code: MONTBLANC
Sponsor: Klinikum der Universitaet Muenchen AöR (Hospital/Clinic/Other health care facility). Phase: Therapeutic exploratory (Phase II). Countries: Germany (ongoing, recruitment ended), Italy (ongoing, recruitment ended).
Therapeutic area(s): Diseases [C] - Neoplasms [C04]
Gender: Female, Male. Age: 18-64 years, 65+ years. Enrolment: 70.
Status: Ongoing, recruitment ended. Start date (EU): 2023-03-30. Decision date: 2024-06-06. Results received: No. Last updated: 2026-03-06.
Decision dates by country: DE: 2024-06-06, IT: 2025-03-19

Condition(s): non-resectable hepatocellular carcinoma (HCC)
Product: IMFINZI 50 mg/mL concentrate for solution for infusion., TREMELIMUMAB, Aybintio 25 mg/ml concentrate for solution for infusion.

Primary endpoint: Objective response rate (ORR)
Endpoint(s): Overall survival (OS), Progression-free survival (PFS), Time to progression (TTP), Objective response rate acc. to BICR (ORR-BICR), Duration of response (DOR), Disease control rate (DCR), Proportion of patients alive at 18 months (OS-18m), Proportion of patients alive at 24 months ((OS-24m), Progression-free survival from escalation treatment (PFS-E), PFS on next treatment, time to failure of strategy (TTFS), quality of life (a) European Organisation for Research and Treatment of Cancer (EORTC) 30-item core quality of life questionnaire (QLQC30): Change compared to baseline, Time to deterioration in global health status/QoL, functioning scales. b) EORTC 18-item hepatocellular cancer health-related quality of life questionnaire (QLQ-HCC18): Change compared to baseline)., Time to deterioration of liver function, defined as time from randomization to worsening of CTCAE grade compared with baseline and persisting for ≥ 30 days for any of these parameters: aspartate aminotransferase (AST), alanine aminotransferase (ALT), total bilirubin, albumin, and international normalized ratio (INR), Adverse events and laboratory findings

Source: https://euclinicaltrials.eu/ctis-public/view/2024-511439-84-00